EU clinical trial 2024-511267-28-00: An Open-label, Multi-center, Long-term Extension Study of Zanubrutinib (BGB-3111) Regimens in Patients with B-cell Malignancies
Protocol code: BGB-3111-LTE1
Sponsor: BeOne Medicines AG (Pharmaceutical company). Phase: Therapeutic confirmatory (Phase III). Countries: Netherlands (ongoing, recruitment ended), Sweden (ongoing, recruitment ended), Germany (ended), Italy (ongoing, recruitment ended), Poland (ongoing, recruitment ended), Greece (ongoing, recruitment ended), Spain (ongoing, recruitment ended), Czechia (ongoing, recruitment ended), France (ongoing, recruitment ended).
Therapeutic area(s): Diseases [C] - Neoplasms [C04]
Gender: Female, Male. Age: 18-64 years, 65+ years. Enrolment: 343.
Start date (EU): 2021-02-17. Decision date: 2024-03-07. Results received: No. Last updated: 2026-07-20.
Decision dates by country: DE: 2024-03-11, FR: 2024-03-21, SE: 2024-03-07, NL: 2024-03-11, CZ: 2024-03-07, ES: 2024-03-11, IT: 2024-03-11, GR: 2024-04-23, PL: 2024-03-12

Condition(s): B-cell malignancies
Product: Zanubrutinib

Primary endpoint: The primary endpoint of the study is safety as assessed by incidence of all TEAEs and SAEs.
Endpoint(s): Progression-free Survival per investigator assessment, Duration of Response per investigator assessment, Overall Survival

Source: https://euclinicaltrials.eu/ctis-public/view/2024-511267-28-00